EU clinical trial 2024-514831-34-00: A prospective, open-label, single-center phase 3 superiority study to assess the clinical nodal stage (cN-stage) accuracy of ferumoxtran-10 -enhanced Magnetic Resonance Imaging (MRI) and unenhanced MRI in reference to histopathologic pN-stage in newly diagnosed rectal cancer (RC) patients, scheduled for direct surgery or short course radiotherapy prior to surgery.
Sponsor: Varsinais-Suomen hyvinvointialue (Hospital/Clinic/Other health care facility). Phase: Therapeutic confirmatory (Phase III). Countries: Finland (ongoing, recruiting).
Therapeutic area(s): Analytical, Diagnostic and Therapeutic Techniques and Equipment [E] - Diagnosis [E01]
Gender: Female, Male. Age: 18-64 years, 65+ years. Enrolment: 60.
Status: Ongoing, recruiting. Start date (EU): 2024-09-19. Decision date: 2024-06-24. Results received: No. Last updated: 2024-10-24.

Condition(s): Rectal cancer, Mesorectal lymph node metastases
Product: IRON OXIDE, NANOPARTICLES

Primary endpoint: Accuracy
Endpoint(s): positive predictive value, negative predictive value, sensitivity, specificity.

Source: https://euclinicaltrials.eu/ctis-public/view/2024-514831-34-00